EU clinical trial 2025-523557-33-00: A Phase 2a, Multicenter, Randomized, Double-blind, Placebo-controlled Study of NAV-240 in Adult Participants with Moderate-to-Severe Hidradenitis Suppurativa
Protocol code: NAV-240-201
Sponsor: Navigator Medicines Inc. (Pharmaceutical company). Phase: Therapeutic exploratory (Phase II). Countries: Hungary (ongoing, recruiting), Poland (ongoing, recruiting), Germany (ongoing, recruiting), Bulgaria (ongoing, recruiting), Romania (ongoing, recruiting).
Therapeutic area(s): Diseases [C] - Skin and Connective Tissue Diseases [C17]
Gender: Female, Male. Age: 18-64 years, 65+ years. Enrolment: 145.
Status: Ongoing, recruiting. Start date (EU): 2026-04-20. Decision date: 2026-03-25. Results received: No. Last updated: 2026-08-03.
Decision dates by country: BG: 2026-03-26, RO: 2026-03-30, HU: 2026-03-30, PL: 2026-03-27, DE: 2026-03-25

Condition(s): Moderate-to-Severe Hidradenitis Suppurativa
Product: NAV-240, NaCl 0,9 % B. Braun, solution pour perfusion

Primary endpoint: The main endpoint of this study is the percentage of participants achieving Hidradenitis Suppurativa Clinical Response (HiSCR) 75 at Week 16, meaning at least a 75% reduction in inflamed skin bumps [abscess and inflammatory nodule (AN) count ] with no increase in number of abscesses or draining tunnels (channels under the skin that leak fluid or pus) compared to the baseline (start of the study).
Endpoint(s): Percentage of participants achieving skin pain numeric rating scale (NRS) 30 response at Week 16, meaning at least 30% and 2-point reduction in pain scores from baseline, for those with initial NRS scores of 3 or higher., Percentage of participants achieving HiSCR 50 at Week 16 (50% fewer inflamed skin bumps with no increase in abscesses or draining tunnels)., Percentage of participants achieving meaningful improvement in quality of life [Dermatology Life Quality Index (DLQI) reduction (improvement) of 4 or more points] at Week 16 among those with initial DLQI scores of 4 or higher., Percentage of participants experiencing a HS flare (worsening) at Week 16, defined as at least 25% increase in AN Count with an absolute increase of 2 or more compared to baseline., Change in disease severity (measured by the International Hidradenitis Suppurativa Severity Score System or IHS4) from baseline to Week 16., Change in AN count and the number of draining tunnels from baseline to Week 16., Number of participants with treatment-related side effects, serious side effects, and specific side effects of special concern.

Source: https://euclinicaltrials.eu/ctis-public/view/2025-523557-33-00